EU clinical trial 2024-514888-25-00: HepBTer: From fungus to virus, a phase 2a clinical trial investigating the safety and efficacy of terbinafine in chronic hepatitis B patients
Sponsor: Stichting Amsterdam UMC (Hospital/Clinic/Other health care facility). Phase: Therapeutic exploratory (Phase II). Countries: Netherlands (ended).
Therapeutic area(s): Diseases [C] - Virus Diseases [C02]
Gender: Female, Male. Age: 18-64 years. Enrolment: 32.
Status: Ended. Start date (EU): 2024-07-25. End date (EU): 2025-08-21. Decision date: 2024-07-25. Results received: Yes. Last updated: 2024-07-25.

Condition(s): Chronic hepatitis B
Product: Placebo Terbinafine 250 mg capsules, Terbinafine Mylan 250 mg, tabletten

Primary endpoint: - Decline in level of serum HBsAg >0.32log10 IU/mL in both groups A and B (week 10 vs baseline) - Decline in serum HBV DNA >0.86log10 in group A at the end of study treatment (week 10 vs baseline)
Endpoint(s): - Safety and tolerability of terbinafine as mono- or combination therapy.

Source: https://euclinicaltrials.eu/ctis-public/view/2024-514888-25-00